EU clinical trial 2024-510869-42-00: Effect of antifibrotic therapy on regression of myocardial fibrosis after transcatheter aortic valve implantation (TAVI) in aortic stenosis patients with high fibrotic burden
Sponsor: Universitaetsmedizin Goettingen (Hospital/Clinic/Other health care facility). Phase: Therapeutic exploratory (Phase II). Countries: Germany (ended).
Therapeutic area(s): Diseases [C] - Cardiovascular Diseases [C14]
Gender: Female, Male. Age: 18-64 years, 65+ years. Enrolment: 150.
Status: Ended. Start date (EU): 2022-02-28. End date (EU): 2026-02-24. Decision date: 2024-07-26. Results received: No. Last updated: 2025-06-27.

Condition(s): aortic stenosis patients with high fibrotic burden
Product: Aldactone® 25, 25 mg überzogene Tabletten, Nepresol®, 25 mg Tabletten

Primary endpoint: Differences between treatment groups in reduction of extracellular volume (ECV)- derived matrix volume (measured by CMR) after 12 months

Source: https://euclinicaltrials.eu/ctis-public/view/2024-510869-42-00